EU clinical trial 2025-521251-24-00: Phase II randomized clinical trial for evaluating the safety and feasibility of fecal microbiota transplant (FMT) in stage II-III non-small cell lung cancer (NSCLC) patients, using immune checkpoint inhibitors (ICI) responders as donors. MIGRANT GECP 24/02
Protocol code: GECP 24/02_MIGRANT
Sponsor: Fundacion GECP (Patient organisation/association). Phase: Therapeutic exploratory (Phase II). Countries: Spain (authorised, recruiting).
Therapeutic area(s): Diseases [C] - Neoplasms [C04]
Gender: Female, Male. Age: 18-64 years, 65+ years. Enrolment: 68.
Status: Authorised, recruiting. Start date (EU): 2025-12-01. Decision date: 2025-09-08. Results received: No. Last updated: 2026-03-17.

Condition(s): Non-Small cell lung cancer (NSCLC)
Product: Carboplatino Teva 10 mg/ml Concentrado para solución para perfusión, Spiraxin 200 mg comprimidos recubiertos con película, IMFINZI 50 mg/mL concentrate for solution for infusion, Paclitaxel Teva 6 mg/ml concentrado para solución para perfusión EFG

Primary endpoint: The primary objective is to evaluate the pathological Complete Response (pCR) rate in the intention to treat population (ITT population) Pathological Complete Response (pCR) defined as the absence of residual tumor in lung and lymph nodes after surgery.
Endpoint(s): 1. Progression free survival (PFS) rate at 12 and 24 months, 2. Overall survival (OS) rate at 12 and 24 months of treatment, 3. Resectability rate (%), 4. Proportion of R0 resections (%), 5. Safety and tolerability of the treatment: Adverse events graded according to CTCAEv 5.0

Source: https://euclinicaltrials.eu/ctis-public/view/2025-521251-24-00